EU clinical trial 2024-516594-71-01: Clinical trial phase IIb multicenter, double-blind, randomized, placebo-controlled trial evaluating the efficacy of intracoronary infusion of autologous adult mononuclear bone marrow unexpanded on functional recovery in patients with dilated cardiomyopathy of idiopathic origin and heart failure.
Protocol code: CMMo-MD-2013
Sponsor: Red Andaluza De Diseno Y Traslacion De Terapias Avanzadas Fundacion Publica Andaluza Progreso Y Salud (Hospital/Clinic/Other health care facility). Phase: Therapeutic exploratory (Phase II). Countries: Spain (ended).
Therapeutic area(s): Diseases [C] - Cardiovascular Diseases [C14]
Gender: Female, Male. Age: 18-64 years, 65+ years. Enrolment: 51.
Status: Ended. Start date (EU): 2013-12-12. End date (EU): 2020-09-23. Decision date: 2024-10-08. Results received: No. Last updated: 2024-10-08.

Condition(s): Idiopathic dilated cardiomyopathy
Product: PLACEBO, Autologous bone marrow adult mononuclear cells not expanded

Primary endpoint: Changes in ventricular function determined angiographically.
Endpoint(s): EFFICACY - PATIENT. Changes in the following parameters: Clinical evaluation and determination of NYHA functional class; Determination of BNP or NT fragment; Full echocardiogram; Assessment of functional capacity by exercise test without measurement of oxygen consumption; And cardiac catheterization., EFFICACY - PATIENT. Evolution time from the diagnosis of idiopathic MD to the inclusion of the patient in the clinical trial., EFFICACY - PATIENT. The degree of clinical improvement based on the absence of major cardiac events (MACE) during follow-up (severe arrhythmias, all cause death, cardiac death, cardiac hospitalization, inclusion in heart transplantation waiting list)., EFFICACY - PATIENT. The presence or absence of symptoms or arrhythmias and clinical functional degree. To this end, patients will be followed closely from a clinical point of view, with frequent telephone calls and periodic hospital check-ups on an outpatient basis., EFFICACY - Laboratory of the cellular therapy medicinal product: Automatic cell counting to determine the total cellularity infused; Determination of the cellular composition in terms of the content of immature progenitors, endothelial line progenitors, mesenchymal line progenitors, expression of adhesion molecules, contamination of red blood cells in the cellular content and expression of the various membrane markers; Functional analysis of the chemotactic capacity of the infused cells., SAFETY. Adverse events and Laboratory determinations: Cellular therapy medicinal product (microbiological cultivation) and Analytical determinations of blood count, plasma coagulation study and biochemistry on the patient.

Source: https://euclinicaltrials.eu/ctis-public/view/2024-516594-71-01